EU clinical trial 2023-504264-41-00: A Phase I/II, Open-Label, Single-Arm, Two-Part Trial to Evaluate Safety, Tolerability, Pharmacokinetics, and Anti-Tumor Activity of Glofitamab in Monotherapy and in Combination with Chemoimmunotherapy in Pediatric and Young Adult Participants with Relapsed/Refractory Mature B-Cell Non−Hodgkin Lymphoma
Protocol code: CO43810
Sponsor: F. Hoffmann-La Roche AG (Pharmaceutical company). Phase: Phase I and Phase II (Integrated)- Other. Countries: France (ongoing, recruiting), Italy (ongoing, recruiting), Denmark (ongoing, recruiting), Germany (ongoing, recruiting), Spain (ongoing, recruiting), Czechia (ongoing, recruiting), Hungary (authorised, recruiting), Poland (authorised, recruiting).
Therapeutic area(s): Health Care [N] - Environment and Public Health [N06]; Diseases [C] - Neoplasms [C04]
Gender: Female, Male. Age: 0-17 years, 18-64 years. Enrolment: 37.
Start date (EU): 2022-11-04. Decision date: 2024-03-26. Results received: No. Last updated: 2026-03-30.
Decision dates by country: DK: 2024-03-26, ES: 2024-04-01, CZ: 2025-07-29, IT: 2024-03-27, FR: 2024-04-15, PL: 2025-08-04, DE: 2024-03-27, HU: 2025-07-09

Condition(s): CD20 positive B-Cell Non-Hodgkin Lymphoma (NHL)
Product: IFOSFAMIDE, MabThera 500 mg concentrate for solution for infusion, ETOPOSIDE, Gazyvaro 1,000 mg concentrate for solution for infusion., CD20 CD3 TCB, RoActemra 20 mg/mL concentrate for solution for infusion, CARBOPLATIN

Primary endpoint: Cohort A - Glofitamab Combination Therapy (glofitamab plus R-ICE chemoimmunotherapy) 1. Achievement of a complete response (CR) after up to three cycles of treatment as determined by the investigator according to the International Pediatric NHL Response Criteria for pediatric participants and Lugano Classification for young adult participants, Cohort A - Glofitamab Combination Therapy (glofitamab plus R-ICE chemoimmunotherapy) 2. Incidence, nature, frequency, severity, and timing of adverse events, with severity determined according to National Cancer Institute Common Terminology Criteria for Adverse Events, version 5 (NCI CTCAE v5.0) (glofitamab plus R-ICE chemoimmunotherapy), Cohort A - Glofitamab Combination Therapy (glofitamab plus R-ICE chemoimmunotherapy) 3. Change from baseline in physical findings, vital signs, clinical laboratory test results and electrocardiogram (ECG) parameters, 4. Pharmacokinetics (PK) parameters (as appropriate) and serum concentrations of glofitamab monotherapy at specified timepoints, 5. PK parameters (as appropriate) and serum concentrations of glofitamab in combination with R-ICE chemoimmunotherapy at specified timepoints
Endpoint(s): 1. For glofitamab plus R-ICE chemoimmunotherapy: Objective response rate (ORR), Duration of complete response (DOCR), Progression-free survival (PFS) after enrollment, Event-free survival (EFS), Overall survival (OS) and percentage of patients who proceed to HSCT after up to three cycles of treatment, 2. For glofitamab monotherapy: ORR, Duration of response (DOR) and OS, Glofitamab monotherapy 3. Incidence, nature, frequency, severity, and timing of adverse events, with severity determined according to NCI CTCAE v5.0, Glofitamab monotherapy 4. Change from baseline in physical findings, vital signs, clinical laboratory test results and ECG parameters, 5. Serum concentrations of obinutuzumab at specified timepoints, 6. Serum concentrations of rituximab at specified timepoints, 7. Prevalence of anti-drug antibodies (ADAs) at baseline and incidence of ADAs against glofitamab during the study

Source: https://euclinicaltrials.eu/ctis-public/view/2023-504264-41-00